EU clinical trial 2024-515641-42-00: Single-blind randomized clinical trial in premature infants with Respiratory Distress Syndrome (RDS) eligible for treatment with exogenous surfactant identified early by lung ultrasonography.
Sponsor: Fundacio Institut De Recerca De L'Hospital De La Santa Creu I Sant Pau (Hospital/Clinic/Other health care facility). Phase: Therapeutic exploratory (Phase II). Countries: Spain (ongoing, recruiting).
Therapeutic area(s): Diseases [C] - Respiratory Tract Diseases [C08]
Gender: Female, Male. Age: 0-17 years. Enrolment: 30.
Status: Ongoing, recruiting. Start date (EU): 2024-06-26. Decision date: 2024-06-26. Results received: No. Last updated: 2025-10-16.

Condition(s): Premature infants with Respiratory Distress Syndrome (RDS)
Product: Curosurf, 240 mg/3 ml, suspensão para instilação endotraqueobrônquica

Primary endpoint: Intubation rate in the next 72 hours of life.

Source: https://euclinicaltrials.eu/ctis-public/view/2024-515641-42-00